EU clinical trial 2023-506194-35-00: PUMP-IT RCT: Hepatic arterial infusion PUMP chemotherapy combined with systemic therapy versus systemic therapy alone as Induction Therapy for initially unresectable colorectal liver metastases: a randomised controlled trial
Sponsor: Het Nederlands Kanker Instituut-Antoni van Leeuwenhoek Ziekenhuis Stichting (Hospital/Clinic/Other health care facility). Phase: Therapeutic confirmatory (Phase III). Countries: Netherlands (ongoing, recruiting).
Therapeutic area(s): Diseases [C] - Digestive System Diseases [C06]; Analytical,Diagnostic,Therapeutic Techniques and Equipment [E]-Surgical Procedures, Operative [E04]; Analytical, Diagnostic and Therapeutic Techniques and Equipment [E] - Therapeutics [E02]; Diseases [C] - Neoplasms [C04]
Gender: Female, Male. Age: 18-64 years, 65+ years. Enrolment: 306.
Status: Ongoing, recruiting. Start date (EU): 2026-05-22. Decision date: 2024-07-03. Results received: No. Last updated: 2026-05-18.

Condition(s): Colorectal liver metastases
Product: CALCIUM FOLINATE, OXALIPLATIN, BEVACIZUMAB, IRINOTECAN, HEPARIN, CAPECITABINE, DEXAMETHASONE, FLUOROURACIL

Primary endpoint: Overall Survival (OS)
Endpoint(s): Progression-free Survival (PFS), Hepatic Progression-free Survival (hPFS), Conversion to resection rate, Objective response rate (ORR), Disease Control Rate (DCR), Pathological response rate, Surgical complication rate (Clavien Dindo classification), Adverse events and toxicity ≥ 3 (according to Common Terminology Criteria for Adverse Events (CTCAE), version 5.0), Quality of Life (QoL), Costs per quality adjusted life years (QALYs)

Source: https://euclinicaltrials.eu/ctis-public/view/2023-506194-35-00